EU clinical trial 2024-519384-18-00: A Phase 2/3, Multicenter, Open-Label, Non-Randomized Study to Evaluate Diagnostic Performance of GEH300079 (68Ga) Injection Positron-Emission Tomography (PET)/Computed Tomography (CT) for Detection of Peritoneal Carcinomatosis (PC) in Patients with Colorectal, Gastric, Ovarian, or Pancreatic Cancers (PERISCOPE)
Protocol code: GE-282-201
Sponsor: GE Healthcare Limited (Pharmaceutical company). Phase: Phase II and Phase III (Integrated). Countries: Sweden (authorised, recruiting), Netherlands (authorised, recruitment pending).
Therapeutic area(s): Analytical, Diagnostic and Therapeutic Techniques and Equipment [E] - Diagnosis [E01]
Gender: Female, Male. Age: 18-64 years, 65+ years. Enrolment: 15.
Start date (EU): 2026-04-29. Decision date: 2026-02-25. Results received: No. Last updated: 2026-06-02.
Decision dates by country: SE: 2026-02-25, NL: 2026-06-02

Condition(s): Colorectal, Gastric, Ovarian or Pancreatic Cancer
Product: FAPI-46 (68Ga)

Primary endpoint: Phase 2 Efficacy Endpoints: Co-Primary Endpoints: • Per-region sensitivity of GEH300079 (68Ga) PET/CT imaging to detect PC, superior to a pre-specified threshold of 75% and • Per-region specificity of GEH300079 (68Ga) PET/CT imaging to detect PC, superior to a pre-specified threshold of 70%, Phase 2 Exploratory Endpoints: • SUVmean and SUVmax thresholds that best discriminate Positive and Negative PC lesions • Detection of primary lesions per participant by GEH300079 (68Ga) PET/CT as compared to baseline SoC imaging, based on on-site read, Phase 2 Exploratory Endpoints: • Number of organs/anatomic structures with potential extra-PC metastases (including involvement in viscera, bones, lymph nodes) identified on GEH300079 (68Ga) PET/CT and baseline SoC imaging per participant, and percentage of participants with at least 1 organ/anatomic structure with potential extra-PC metastases identified by GEH300079 (68Ga) PET/CT scan as compared to baseline SoC imaging, based on on-site read, Phase 2 Safety Endpoints: Adverse events: • Incidence of treatment-emergent AEs (TEAEs) by Medical Dictionary for Regulatory Activities (MedDRA) system organ class and preferred term (PT) Urinalysis and clinical laboratory parameters: • Observed values and changes from baseline • Occurrence of changes from baseline values of >40% and >80% of the span of the normal limits • Occurrence of post-administration values outside the normal limits, Phase 2 Safety Endpoints: Vital signs (BP, RR, HR, body temperature): • Observed values and changes from baseline • Occurrence of changes from baseline greater than a pre-specified magnitude (20 mmHg for systolic BP, 10 mmHg for diastolic BP, 10 beats per minute for HR, 10 breaths per minute for RR, 1.5°C for body temperature) • Occurrence of post-administration values outside the normal limits, Phase 2 Safety Endpoints: Electrocardiography: • Observed values and changes from baseline • Occurrence of changes from baseline within the following pre-specified increments: • Increments of 4 ms (<4, ≥4 to ≤8, >8 to ≤12, and >12 ms), 10 ms (<10, ≥10 to ≤20, and >20 ms) and 25 ms (<25, ≥25 to ≤50, and >50 ms) for PR interval • <30 ms, ≥30 to ≤60 ms, and >60 ms increments for QTcF interval, Phase 2 Safety Endpoints: Electrocardiography: • <50 ms, ≥50 to ≤100 ms, and >100 ms increments for QRS interval • <250 ms, ≥250 to ≤500 ms, and >500 ms increments for RR interval • Occurrence of post-administration values outside the normal limits in the PR, QTc, QRS or RR interval • Overall interpretation at each post-administration time point Physical examination: • Occurrence of changes from baseline in physical examination status (normal/abnormal), Phase 3: Efficacy Endpoints: • Per-region sensitivity of GEH300079 (68Ga) PET/CT imaging for the detection of PC, superior to a prespecified threshold of 75% and • Per-region specificity of GEH300079 (68Ga) PET/CT imaging for the detection of PC, superior to a prespecified threshold of 70%, Phase 3: Exploratory Endpoints: • SUVmean and SUVmax thresholds that best discriminate Positive and Negative PC lesions • Detection of primary lesions per participant by GEH300079 (68Ga) PET/CT as compared to baseline SoC imaging, based on on-site read, Phase 3: Exploratory Endpoints: • Number of organs/anatomic structures with potential extra-PC metastases (including involvement in viscera, bones, lymph nodes) identified on GEH300079 (68Ga) PET/CT and baseline SoC imaging per participant, and percentage of participants with at least 1 organ/anatomic structure with potential extra-PC metastases identified by GEH300079 (68Ga) PET/CT scan as compared to baseline SoC imaging, based on on-site read, Phase 3: Safety Endpoints: AEs: • Incidence of TEAEs by MedDRA system organ class and PT Urinalysis and clinical laboratory parameters: • Observed values and changes from baseline • Occurrence of changes from baseline values of >40% and >80% of the span of the normal limits • Occurrence of post-administration values outside the normal limits, Phase 3: Safety Endpoints: Vital signs (BP, RR, HR, body temperature): • Observed values and changes from baseline • Occurrence of changes from baseline greater than a pre-specified magnitude (20 mmHg for systolic BP, 10 mmHg for diastolic BP, 10 beats per minute for HR, 10 breaths per minute for RR, 1.5°C for body temperature), Phase 3: Safety Endpoints: Vital signs (BP, RR, HR, body temperature): • Occurrence of post-administration values outside the normal limits Physical examination: • Occurrence of changes from baseline in physical examination status (normal/abnormal)
Endpoint(s): Phase 2: Efficacy Endpoints: Co-key Secondary Endpoints: I. Superiority of the per region sensitivity of GEH300079 (68Ga) PET/CT to detect PC compared to baseline SoC imaging (i.e., CT, MR, or [18F]FDG PET/CT) and II. Non-inferiority of the per region specificity of GEH300079 (68Ga) PET/CT to detect PC compared to baseline SoC imaging, Phase 3: Efficacy Endpoints: Co-Key Secondary Endpoints: I. Superiority of the per region sensitivity of GEH300079 (68Ga) PET/CT to detect PC compared to baseline SoC imaging (i.e., CT, MR or [18F]FDG PET/CT) and II. Non-inferiority of the per region specificity of GEH300079 (68Ga) PET/CT to detect PC compared to baseline SoC imaging

Source: https://euclinicaltrials.eu/ctis-public/view/2024-519384-18-00